EU clinical trial 2024-512642-42-00: Randomized study to protect from radiation iatrogenic hypothyroidism patients with medulloblastoma (any stage, any biological risk) and pediatric patients with Hodgkin lymphoma and non-Hodgkin lymphoma needing radiation therapy on thyroid site - WINHYPO 2021
Sponsor: Fondazione IRCCS Istituto Nazionale Dei Tumori (Hospital/Clinic/Other health care facility). Phase: Therapeutic confirmatory (Phase III). Countries: Italy (ongoing, recruiting).
Therapeutic area(s): Diseases [C] - Neoplasms [C04]
Gender: Female, Male. Age: 0-17 years, 18-64 years, 65+ years. Enrolment: 65.
Status: Ongoing, recruiting. Start date (EU): 2021-12-13. Decision date: 2024-05-24. Results received: No. Last updated: 2024-05-24.

Condition(s): Hodgkin and non Hodgkin lymphoma, Medulloblastoma
Product: Levotiroxina Teva 25 microgrammi compresse

Primary endpoint: Hypothyroidism-free survival at 3 years after radiotherapy including part or the whole thyroid parenchima on the intention-to-treat population will be the main end-point. For both treatment groups (radiotherapy / radiotherapy + Levo-thyroxin), the analysis set will consist of patients evaluated with TSH blood dosage to evaluate the onset of hypothyroidism within three years from the radiotherapy beginning.

Source: https://euclinicaltrials.eu/ctis-public/view/2024-512642-42-00